EU clinical trial 2024-520109-37-00: A Phase 2b, Multicenter, Double-blind, Randomized, Placebo controlled Study to Assess the Efficacy and Safety of Weekly Doses of GLM101 Administered Intravenously to Participants with PMM2-CDG
Protocol code: GLM101-003
Sponsor: Glycomine Inc. (Pharmaceutical company). Phase: Therapeutic exploratory (Phase II). Countries: Italy (ongoing, recruitment ended), Poland (ongoing, recruitment ended), Czechia (ongoing, recruitment ended), France (ongoing, recruitment ended), Spain (ongoing, recruitment ended), Portugal (ongoing, recruitment ended), Belgium (ongoing, recruitment ended), Germany (ongoing, recruitment ended).
Therapeutic area(s): Diseases [C] - Nutritional and Metabolic Diseases [C18]
Gender: Female, Male. Age: 0-17 years, 18-64 years, 65+ years. Enrolment: 45.
Status: Ongoing, recruitment ended. Start date (EU): 2025-07-09. Decision date: 2025-06-10. Results received: No. Last updated: 2026-08-07.
Decision dates by country: DE: 2025-06-11, IT: 2025-06-11, PT: 2025-07-17, ES: 2025-06-12, FR: 2025-06-10, PL: 2025-06-16, CZ: 2025-08-20, BE: 2025-06-10

Condition(s): PMM2-CDG
Product: GLM101, 0.9% Sodium Chloride Intravenous Infusion Solution, GLM101

Primary endpoint: Change from Baseline in ICARS at 24 weeks
Endpoint(s): 1. Change from Baseline in GRO at 24 weeks, 2.Change from Baseline in SARA at 24 weeks, 3.Changes from Baseline in participants and caregiver global impression of change (overall, ataxia, and gross motor function) and global impression of severity (ataxia and gross motor function) and clinician global impression of improvement (overall), global impression of change (ataxia and gross motor function), and global impression of severity (ataxia and gross motor function) at 24 weeks, 4.Evaluation of safety throughout 24 weeks through the collection of safety parameters: o AEs, AESIs (including IARs), SAEs, deaths, and discontinuations due to AEs o Clinical safety laboratory tests o Immunogenicity o ECG, vital signs, and PE findings, 5.Change from Baseline to Week 24 compared to the change from Week 24 to Week 48 in ICARS for participants who switched from placebo to GLM101 treatment at Week 24, 6.Change from Baseline in ICARS for participants randomized to placebo in Part A and who switched to active treatment in Part B compared to change from Baseline in ICARS in participants who were randomized to GLM101 from the beginning of the study in order to compare the GLM101 effect between the early start group and the delayed start group, 7. Visit-wise changes from Baseline in ICARS up to 48 weeks of GLM101 treatment in participants who were initially randomized to GLM101, 8. Change from Baseline to Week 24 compared to the change from Week 24 to Week 48 in GRO for participants who switched from placebo to GLM101 treatment at Week 24, 9. Change from Baseline in GRO for participants randomized to placebo in Part A and who switched to active treatment in Part B compared to change from Baseline in GRO in participants who were randomized to GLM101 from the beginning of the study in order to compare the GLM101 effect between the early start group and the delayed start group, 10. Visit-wise changes from Baseline in GRO up to 48 weeks of GLM101 treatment in participants who were initially randomized to GLM101, 11. Change from Baseline to Week 24 compared to the change from Week 24 to Week 48 in SARA for participants who switched from placebo to GLM101 treatment at Week 24, 12. Change from Baseline in SARA for participants randomized to placebo in Part A and who switched to active treatment in Part B compared to change from Baseline in SARA in participants who were randomized to GLM101 from the beginning of the study in order to compare the GLM101 effect between the early start group and the delayed start group, 13. Visit-wise changes from Baseline in SARA up to 48 weeks of GLM101 treatment in participants initially randomized to GLM101, 14.Visit-wise changes in participants and caregiver global impression of change (overall, ataxia and gross motor function) and global impression of severity (ataxia and gross motor function) and clinician global impression of improvement (overall), global impression of change (ataxia and gross motor function), and global impression of severity (ataxia and gross motor function) up to 48 weeks of dosing, 15.Evaluation of safety through 48 weeks of GLM101 treatment through the collection of safety parameters: o AEs, AESIs (including IARs), SAEs, deaths, and discontinuations due to AEs o Clinical safety laboratory tests o Immunogenicity o ECG, vital signs, and PE findings, 16.Concentrations of total M1P to estimate PK parameters including Cmax, Clast, tmax, tlast, t1/2, AUC0-last, AUC0-∞, AUC0-tau, CL, Vz, Vss, and λz

Source: https://euclinicaltrials.eu/ctis-public/view/2024-520109-37-00